EU clinical trial 2022-501615-14-00: Phase 2 Study of Pembrolizumab and Chemotherapy in Patients With Newly Diagnosed Classical Hodgkin Lymphoma (KEYNOTE-C11)
Protocol code: MK-3475-C11
Sponsor: Merck Sharp & Dohme LLC (Pharmaceutical company). Phase: Therapeutic exploratory (Phase II). Countries: France (ended), Poland (ended), Spain (ended), Italy (ended).
Therapeutic area(s): Diseases [C] - Neoplasms [C04]
Gender: Female, Male. Age: 18-64 years, 65+ years. Enrolment: 50.
Status: Ended. Start date (EU): 2021-11-08. End date (EU): 2024-05-21. End date: 2024-05-26. Decision date: 2023-08-25. Results received: Yes. Last updated: 2024-04-02.
Decision dates by country: ES: 2023-08-25, PL: 2023-09-04, IT: 2023-08-29, FR: 2023-08-28

Condition(s): Classical Hodgkin Lymphoma
Product: DOXORUBICIN, ETOPOSIDE, VINBLASTINE, BLEOMYCIN, VINCRISTINE, PREDNISONE, CYCLOPHOSPHAMIDE, DACARBAZINE, PROCARBAZINE, KEYTRUDA 25 mg/mL concentrate for solution for infusion

Primary endpoint: Complete Response (CR) at the End of Study Intervention as Assessed by Independent Central Review Per Lugano 2014 Response Criteria
Endpoint(s): CR at the End of Study Intervention as Assessed by Investigator Per Lugano 2014 Response Criteria, Duration of Complete Response (DurCR) as Assessed by Independent Central Review Per Lugano 2014 Response Criteria, Positron Emission Tomography (PET) Negativity by Independent Central Review Per 2-Fluorodeoxyglucose (FDG)-PET 5-point Scale After Administration of Pembrolizumab Monotherapy, PET Negativity by Independent Central Review Per FDG-PET 5-point Scale After Administration of Pembrolizumab Monotherapy and Chemotherapy, Number of Participants Who Experienced an Adverse Event (AE), Number of Participants Who Discontinued Study Treatment Due to an AE

Source: https://euclinicaltrials.eu/ctis-public/view/2022-501615-14-00